EU clinical trial 2022-502238-22-00: A Phase 3 Randomized, Open-label Induction, Double-blind Maintenance, Parallel-group, Multicenter Protocol to Evaluate the Efficacy, Safety, and Pharmacokinetics of Guselkumab in Pediatric Participants with Moderately to Severely Active Ulcerative Colitis
Protocol code: CNTO1959PUC3001
Sponsor: Janssen - Cilag International (Pharmaceutical company). Phase: Therapeutic confirmatory (Phase III). Countries: France (ended), Poland (ongoing, recruitment ended), Spain (ended), Norway (ended), Portugal (ended), Italy (ongoing, recruitment ended), Denmark (ended), Belgium (ended).
Therapeutic area(s): Diseases [C] - Immune System Diseases [C20]
Gender: Female, Male. Age: 0-17 years. Enrolment: 79.
Start date (EU): 2024-05-14. Decision date: 2024-03-04. Results received: No. Last updated: 2026-02-05.
Decision dates by country: NO: 2024-03-08, BE: 2024-03-05, PT: 2024-03-07, IT: 2024-03-11, PL: 2024-03-11, DK: 2024-03-21, FR: 2024-03-11, ES: 2024-03-11

Condition(s): Ulcerative Colitis
Product: Guselkumab 1 mL PFS Placebo, Guselkumab, Guselkumab - solution for injection in pre-filled syringe - 100 mg/mL, Guselkumab 2 mL PFS Placebo, Guselkumab 0.5 mL Varioject Placebo, Guselkumab, Guselkumab- Solution for infusion- 10 mg/ml

Primary endpoint: Clinical remission (modified Mayo) at Week 56

Source: https://euclinicaltrials.eu/ctis-public/view/2022-502238-22-00